EU clinical trial 2024-517840-68-00: A phase 2 clinical trial on neoadjuvant pembrolizumab in patients diagnosed with high-risk melanoma without clinical evidence of metastatic dissemination.
Sponsor: UZ Brussel (Hospital/Clinic/Other health care facility). Phase: Therapeutic exploratory (Phase II). Countries: Belgium (ongoing, recruiting).
Therapeutic area(s): Diseases [C] - Pathological Conditions, Signs and Symptoms [C23]
Gender: Female, Male. Age: 18-64 years, 65+ years. Enrolment: 49.
Status: Ongoing, recruiting. Start date (EU): 2025-04-11. Decision date: 2025-03-07. Results received: No. Last updated: 2026-06-05.

Condition(s): Melanoma
Product: KEYTRUDA 25 mg/mL concentrate for solution for infusion

Primary endpoint: The rate of negative sentinel node procedures (=absence of viable melanoma metastases found on histopathological examination of the sentinel node) following the neoadjuvant treatment.
Endpoint(s): RFS is defined as the time from study recruitment to the date of first recurrence (or death from any cause), DMFS from recruitment to the first diagnosis of a distant metastasis (or death from any cause) and OS is defined as the time of recruitment until the date of death from any cause., Safety as assessed by anamnesis, clinical examination, analysis of blood and any additional medical examination that is indicated. AE will be graded by the Common Terminology Criteria of Adverse events (CTCAE), version 5.0 (National Institutes of Health, National Cancer Institute)., Health-related quality of life through the following patient-reported outcomes measure (PROM): European Organization for Research and Treatment of Cancer Quality of Life Questionnaire C30 (EORTC-QLQ-C30)., Describe markers of pathological response of melanoma micrometastasis in the sentinel node., Describe the relation between the gene expression signature in bulk RNA sequencing of the primary tumor and the result of the sentinel node biopsy.

Source: https://euclinicaltrials.eu/ctis-public/view/2024-517840-68-00